EU clinical trial 2024-516839-27-00: MITO 35a: a multicenter, prospective, single arm trial of Olaparib maintenance therapy in newly diagnosed BRCA wild-type advanced ovarian, fallopian tube and primitive peritoneal cancer
Protocol code: MITO 35a
Sponsor: IRCCS Istituto Nazionale Tumori Fondazione Pascale (Hospital/Clinic/Other health care facility). Phase: Therapeutic exploratory (Phase II). Countries: Italy (ongoing, recruiting).
Therapeutic area(s): Diseases [C] - Neoplasms [C04]
Gender: Female. Age: 18-64 years, 65+ years. Enrolment: 200.
Status: Ongoing, recruiting. Start date (EU): 2024-12-09. Decision date: 2024-12-09. Results received: No. Last updated: 2026-06-03.

Condition(s): BRCA wild-type advanced ovarian, fallopian tube and primitive peritoneal cancer
Product: Lynparza 100 mg film-coated tablets, Lynparza 150 mg film-coated tablets

Primary endpoint: PFS number of subjects who are progression- free from the beginning of the first line treatment
Endpoint(s): 1) PFS 2 Progression Free Survival 2 2) OS Overall Survival 3) toxicity profile (CTCAE 5.0 version) every 4 weeks (28gg) 4) Define if there are prognostic factors between the biological and clinical characteristics of patients and tumor biomarkers, which can identify patients who have a better prognosis in terms of OS

Source: https://euclinicaltrials.eu/ctis-public/view/2024-516839-27-00